EU clinical trial 2022-500596-32-00: Effect of xenon on brain injury, neurological outcome and survival in patients after aneurysmal subarachnoid hemorrhage
Protocol code: T109/2019Xe-SAH
Sponsor: Turku University Central Hospital (Hospital/Clinic/Other health care facility). Phase: Therapeutic exploratory (Phase II). Countries: Finland (ongoing, recruiting).
Therapeutic area(s): Diseases [C] - Nervous System Diseases [C10]
Gender: Female, Male. Age: 18-64 years, 65+ years. Enrolment: 160.
Status: Ongoing, recruiting. Start date (EU): 2024-10-01. Decision date: 2022-06-22. Results received: No. Last updated: 2025-12-02.

Condition(s): Aneyrysmal subarachnoid hemorrhage needing ventilatory care in intensive care unit
Product: XENON, CONOXIA 100% lääkkeellinen kaasu, kryogeeninen

Primary endpoint: Global fractional anisotropy of white matter of diffusion tensor imaging (DTI). Hypothesis: White matter damage is less severe in xenon treated patients, i.e. global fractional anisotropy is significantly higher in the xenon group than in the control group as assessed with the 1st MRI.
Endpoint(s): Fractional anisotropy of white matter at cerebellum, cerebellar peduncles, hypothalamus, anterior ventral midbrain, cingulum, centrum semiovale and/or at corpus callosum (genu, body, splenium) as assessed with the 1st MRI., Safety and tolerability of xenon as assessed with a ratio of adverse events, serious adverse events and suspected unexpected serious adverse reactions (SUSARs) during the follow-up of one year between the xenon group and the control group., Composite of radiological EBI (within 72 hours after start of SAH symptoms) and DCI (Criterion of DCI, Neurogenic Stress Cardiomyopathy and Stunned Myocardium, ICP level up to 14 days after onset of aSAH symptoms, Need for ICP therapies up to 14 days after onset of aSAH symptoms (hypothermia, decompressive craniotomy), Duration of therapy for ICP control/monitoring up to 14 days after onset of aSAH symptoms, Plasma catecholamine level, Difference of neuron specific enolase (NSE), neurofilament light (NF-L), glial fibrillary acidic protein (GFAP), calcium binding protein S100B (S100B), ubiquitin carboxyterminal hydrolase L1 (UCH-L1), total tau, cytokines (tumour necrosis factor alpha, interleukins 6 and 10) between xenon and control group and in predicting risk for EBI within first 72 hours after start of aSAH symptoms , vasospasm (within 21 days after start of SAH symptoms) and DCI (between day 4 and 6 weeks after start of SAH, Development of prognostication models with a selected combination of brain imaging, biomarkers, clinical data and metabolomics by applying artificial intelligence and machine learning for EBI within first 72 hours after start of aSAH symptoms , vasospasm (within 21 days after start of SAH symptoms) and DCI (between day 4 and 6 weeks after start of SAH symptoms ) and good neurological outcome at 3 moths, at 1 year and at 2 years after SAH (mRS 0-2)., Difference of MRI parameters between xenon and control group and in predicting risk for EBI within first 72 hours after start of aSAH symptoms , vasospasm (within 21 days after start of SAH symptoms) and DCI (between day 4 and 6 weeks after start of SAH symptoms ) and good neurological outcome at 3 moths, at 1 year and at 2 years after SAH (mRS 0-2)., Difference of CTA parameters between xenon and control group and in predicting risk for EBI within first 72 hours after start of aSAH symptoms , vasospasm (within 21 days after start of SAH symptoms) and DCI (between day 4 and 6 weeks after start of SAH symptoms ) and good neurological outcome at 3 moths, at 1 year and at 2 years after SAH (mRS 0-2)., Difference of DSA parameters between xenon and control group and in predicting risk for EBI within first 72 hours after start of aSAH symptoms , vasospasm (within 21 days after start of SAH symptoms) and DCI (between day 4 and 6 weeks after start of SAH symptoms ) and good neurological outcome at 3 moths, at 1 year and at 2 years after SAH (mRS 0-2)., Predictive value CFD simulations in predicting risk for EBI within first 72 hours after start of aSAH symptoms , vasospasm (within 21 days after start of SAH symptoms) and DCI (between day 4 and 6 weeks after start of SAH symptoms ) and good neurological outcome at 3 moths, at 1 year and at 2 years after SAH (mRS 0-2)., Difference of metabolomics of plasma and spinal fluid between xenon and control group and in predicting risk for EBI within first 72 hours after start of aSAH symptoms , vasospasm (within 21 days after start of SAH symptoms) and DCI (between day 4 and 6 weeks after start of SAH symptoms ) and good neurological outcome at 3 moths, at 1 year and at 2 years after SAH (mRS 0-2)., Difference of activity of microglia cells between xenon and control group and in predicting risk for DCI and good neurological outcome at 3 moths, at 1 year and at 2 years after SAH (mRS 0-2)., Safety of the xenon delivery device Akzent X Color used in the xenon group as assessed with ventilator parameters, blood gas values, adverse events and serious events related to the performance of the ventilators. Safety parameters will be compared between the control group and the xenon group in the interim analysis after 80 patients and in the final analysis with the complete population.

Source: https://euclinicaltrials.eu/ctis-public/view/2022-500596-32-00